EU clinical trial 2024-517423-40-00: A Phase 3, Open-label Study of Ifinatamab Deruxtecan Versus Docetaxel in Participants with Metastatic Castration-Resistant Prostate Cancer (mCRPC) (IDeate Prostate01)
Protocol code: MK-2400-001
Sponsor: Merck Sharp & Dohme LLC (Pharmaceutical company). Phase: Therapeutic confirmatory (Phase III). Countries: Norway (ongoing, recruiting), Sweden (ongoing, recruiting), Greece (ongoing, recruiting), Germany (ongoing, recruiting), France (ongoing, recruiting), Spain (ongoing, recruiting), Denmark (ongoing, recruiting), Austria (ongoing, recruiting), Poland (ongoing, recruiting), Italy (ongoing, recruiting), Czechia (ongoing, recruiting), Ireland (ongoing, recruiting), Netherlands (ongoing, recruiting).
Therapeutic area(s): Diseases [C] - Neoplasms [C04]
Gender: Female, Male. Age: 18-64 years, 65+ years. Enrolment: 508.
Status: Ongoing, recruiting. Start date (EU): 2025-06-23. Decision date: 2025-06-10. Results received: No. Last updated: 2026-08-07.
Decision dates by country: AT: 2025-06-11, PL: 2025-06-16, GR: 2025-06-16, IT: 2025-06-13, ES: 2025-06-13, DK: 2025-06-10, SE: 2025-06-10, DE: 2025-06-11, IE: 2025-06-13, FR: 2025-06-13, NO: 2025-06-12, NL: 2025-06-16, CZ: 2025-06-11

Condition(s): Metastatic Castration-Resistant Prostate Cancer
Product: PARACETAMOL, Ifinatamab Deruxtecan, PREDNISONE, DOCETAXEL, PREDNISOLONE

Primary endpoint: Overall Survival (OS), Radiographic Progression-Free Survival (rPFS)
Endpoint(s): Time to First Subsequent Therapy (TFST), Objective Response Rate (ORR), Duration of Response (DOR), Time to Pain Progression (TTPP), Time to Prostate-Specific Antigen (PSA) Progression, PSA Response Rate, Time to First Symptomatic Skeletal-Related Events (SSRE), Number of Participants Who Experience One or More Adverse Events (AEs), Number of Participants Who Discontinue Study Treatment Due to an AE

Source: https://euclinicaltrials.eu/ctis-public/view/2024-517423-40-00